EU clinical trial 2025-520572-25-00: Evaluation of bioequivalence of two products containing 600 mg ibuprofen: Ibuprofen Sopharma 600 mg film-coated tablets (Test) vs. Brufen 600 mg film-coated tablets (Comparator). A monocentric, open, randomized, single dose, two-period, crossover trial in healthy volunteers
Protocol code: CSO24001
Sponsor: CCDRD Cooperative Clinical Drug Research and Development AG, Sopharma AD (Pharmaceutical company). Phase: Human Pharmacology (Phase I)- Bioequivalence Study. Countries: Bulgaria (ended).
Therapeutic area(s): Not possible to specify
Gender: Female, Male. Age: 18-64 years. Enrolment: 30.
Status: Ended. Start date (EU): 2025-09-27. End date (EU): 2025-10-21. Decision date: 2025-08-12. Results received: No. Last updated: 2025-08-12.

Condition(s): No therapeutic indication in the current trial with healthy volunteers.

Source: https://euclinicaltrials.eu/ctis-public/view/2025-520572-25-00